EU clinical trial 2023-510255-34-00: A prospective, multi-centre, open-label, investigator-initiated randomised controlled study investigating calcinosis cutis in patients with systemic sclerosis undergoing treatment with sodium thiosulfate assessed by novel biomarkers and diagnostic imaging
Sponsor: Aarhus Universitetshospital (Hospital/Clinic/Other health care facility). Phase: Therapeutic use (Phase IV). Countries: Denmark (ongoing, recruiting).
Therapeutic area(s): Diseases [C] - Skin and Connective Tissue Diseases [C17]
Gender: Female, Male. Age: 18-64 years, 65+ years. Enrolment: 75.
Status: Ongoing, recruiting. Start date (EU): 2024-06-21. Decision date: 2024-05-22. Results received: No. Last updated: 2026-04-14.

Condition(s): Calcinosis cutis in systemic sclerosis
Product: Natriumthiosulfat, LIDOCAINE

Primary endpoint: Complete remission of CC from week 0 to week 28 [ Time Frame: Week 1, week 5, week 17, week 21, week 28 ] defined as removal of total calcinosis volume in scans and/or clinical complete clearance, Partial remission of CC from week 0 to week 28 [ Time Frame: Week 1, week 5, week 17, week 21, week 28 ] defined as partial removal of calcinosis volume in scans and/or clinical improvement in PtGA score
Endpoint(s): Assessment of treatment efficacy of intralesional STS [ Time Frame: Week 1, week 5, week 17, week 21, week 28 ], Change in CC lesion severity patient- and physician global score, PtGA and PhGA (1-10) [ Time Frame: Week 1, week 5, week 17, week 21, week 28 ], Change in CC lesion seen on imaging (RCM, DECT, and CBCT): size, density, remission (complete/partial) [ Time Frame: Week 1, week 28 ], Comparison of imaging modalities to assess change in CC (RCM, DECT, and CBCT) [ Time Frame: Week 1, week 28 ], Validation of/comparison to the Radiological scoring system for CC [ Time Frame: Week 1, week 28 ] The Radiological scoring system for CC is a newer scoring system to assess severity of CC affecting the hands in patients with SSc developed by the Scleroderma Clinical Trials Consortium. Currently, no standardised outcomes for CC exist. This novel radiographic scoring system accounts for the area coverage, density, and anatomic location of CC affecting the hands in patients with SSc, Clinical assessment: ulcer size, inflammatory surroundings and clinical photos [ Time Frame: Week 1, week 5, week 17, week 21, week 28 ], Changes in biomarkers, measured by blood and skin analyses (e.g., to evaluate changes due to therapy, or differences between responders and non-responders to therapy) [ Time Frame: Week 1, week 5, week 17, week 28 ], Incidence and severity of adverse events, including laboratory abnormalities, over time [ Time Frame: Week 1, week 5, week 17, week 21, week 28 ], QoL outcome: Health Assessment Questionnaire Disability Index (MD-HAQ-) [ Time Frame: Week 1, week 28 ], Change in total calcinosis volume and demonstration of PET/MRI imaging of CC lesions [ Time Frame: Week 28 ]

Source: https://euclinicaltrials.eu/ctis-public/view/2023-510255-34-00